EU clinical trial 2025-525001-21-00: Methoxyflurane versus Standard Care for Non-Traumatic Pain in the Emergency Department (PAIN-THROX) : A Multicenter, Randomized, Controlled, Superiority Trial
Protocol code: DR250268
Sponsor: Centre Hospitalier Regional Universitaire De Tours (Hospital/Clinic/Other health care facility). Phase: Therapeutic confirmatory (Phase III). Countries: France (authorised, recruitment pending).
Therapeutic area(s): Not possible to specify
Gender: Female, Male. Age: 18-64 years, 65+ years. Enrolment: 164.
Status: Authorised, recruitment pending. Decision date: 2026-06-29. Results received: No. Last updated: 2026-06-29.

Condition(s): Non-traumatic pain
Product: PENTHROX 99,9%, liquide pour inhalation par vapeur de 3 mL

Primary endpoint: The primary endpoint will be pain assessed using the Visual Analog Scale (VAS). The VAS is a simple pain assessment tool consisting of marking a point on a color-graded ruler calibrated in millimeters, allowing pain intensity to be assigned a numerical value ranging from 0 (no pain) to 100 mm (unbearable pain). Pain will be assessed at inclusion, at 3 minutes post-randomization, and then at 5, 10, 15, 20, 25, and 30 minutes using self-administered questionnaires.
Endpoint(s): Time to onset of pain relief within the first 30 minutes.Measurement of VAS over the first 30 minutes, Pain measured again using the VAS at 60, 90, and 120 minutes post-randomization via self-administered questionnaires., The need for rescue analgesic treatment of any class due to insufficient pain relief or pain recurrence., Adverse events and serious adverse events reported in each group.

Source: https://euclinicaltrials.eu/ctis-public/view/2025-525001-21-00